EU clinical trial 2024-512231-72-00: SECRET-HF: Treatment of Non-ischemic Dilated Cardiomyopathies by Intravenous Infusions of the Extracellular Vesicle-Enriched Secretome of Cardiovascular Progenitor Cells
Protocol code: APHP200034
Sponsor: Assistance Publique Hopitaux De Paris (Hospital/Clinic/Other health care facility). Phase: Human Pharmacology (Phase I)- First administration to humans. Countries: France (ongoing, recruitment ended).
Therapeutic area(s): Diseases [C] - Cardiovascular Diseases [C14]
Gender: Female, Male. Age: 18-64 years, 65+ years. Enrolment: 12.
Status: Ongoing, recruitment ended. Start date (EU): 2023-05-31. Decision date: 2024-11-08. Results received: No. Last updated: 2025-12-17.

Condition(s): Non-ischemic Dilated Cardiomyopathies

Source: https://euclinicaltrials.eu/ctis-public/view/2024-512231-72-00